EU clinical trial 2022-500747-21-00: Long-term Extension Study for Participants with Geographic Atrophy (GA) Secondary to Age-related Macular Degeneration (AMD) in JNJ-81201887 Parent Clinical Studies
Protocol code: 81201887MDG3002
Sponsor: Janssen - Cilag International (Pharmaceutical company). Phase: Therapeutic exploratory (Phase II). Countries: Belgium (ongoing, recruiting), Hungary (ongoing, recruiting), Poland (ongoing, recruiting), Italy (ongoing, recruiting), Denmark (ongoing, recruiting), Sweden (ongoing, recruiting), Spain (ongoing, recruiting), Netherlands (ongoing, recruiting), Czechia (ongoing, recruiting), Germany (ongoing, recruiting), Portugal (ongoing, recruiting).
Therapeutic area(s): Diseases [C] - Eye Diseases [C11]
Gender: Female, Male. Age: 18-64 years, 65+ years. Enrolment: 120.
Status: Ongoing, recruiting. Start date (EU): 2025-02-27. Decision date: 2024-11-19. Results received: No. Last updated: 2026-07-17.
Decision dates by country: BE: 2024-11-19, CZ: 2024-11-21, ES: 2024-11-22, NL: 2024-11-22, DE: 2024-11-22, SE: 2024-11-21, DK: 2024-11-19, PL: 2024-11-24, IT: 2024-11-21, HU: 2024-11-19, PT: 2024-11-19

Condition(s): Geographic Atrophy
Product: Placebo to match Prednisone 20mg, 5mg, Kenacort-A 40, suspensie voor injectie 40 mg/ml, JNJ-81201887, Prednison acis 5 mg, Tabletten, JNJ-81201887, Prednison acis 20 mg, Tabletten

Primary endpoint: Ocular and systemic treatment-emergent adverse events., Clinical laboratory and safety assessments., Retinal imaging (FAF, SD-OCT, and CFP) and eye examinations.

Source: https://euclinicaltrials.eu/ctis-public/view/2022-500747-21-00